EU clinical trial 2024-517671-21-00: C5091018 - An Interventional Efficacy And Safety, Phase 3, Randomized, Double-Blind, 3-Arm Study To Investigate Ibuzatrelvir in Adults With Symptomatic COVID-19 Who Are Severely Immunocompromised
Protocol code: C5091018
Sponsor: Pfizer Inc. (Pharmaceutical company). Phase: Therapeutic confirmatory (Phase III). Countries: Slovakia (ongoing, recruiting), Germany (authorised, recruiting), Sweden (ongoing, recruiting), Denmark (authorised, recruiting), France (authorised, recruiting), Greece (ongoing, recruiting), Belgium (authorised, recruiting), Netherlands (authorised, recruiting), Spain (ongoing, recruiting).
Therapeutic area(s): Diseases [C] - Virus Diseases [C02]
Gender: Female, Male. Age: 18-64 years, 65+ years. Enrolment: 94.
Start date (EU): 2025-09-30. Decision date: 2025-08-11. Results received: No. Last updated: 2026-05-21.
Decision dates by country: SE: 2025-08-12, NL: 2025-09-08, ES: 2025-10-22, SK: 2025-08-11, DK: 2025-08-12, GR: 2025-08-12, DE: 2025-08-12, FR: 2025-08-12, BE: 2025-10-29

Condition(s): Coronavirus Disease 2019 (COVID-19)
Product: Placebo to Remdesivir - Saline, Remdesivir, PF-07817883 Tablet, Placebo to Ibuzatrelvir

Primary endpoint: Proportion of participants with the composite endpoint of: • COVID-19-related emergency department (ED) visits with administration of supplemental oxygen, COVID-19 antiviral, or intravenous (IV) treatment (eg, hydration, antibiotics, or corticosteroids); COVID-19-related hospitalization; or all-cause mortality by Day 38, or • Evidence of recurrent or persistent SARS-CoV-2 infection, [CCI]
Endpoint(s): Time to sustained alleviation of all targeted COVID-19 symptoms through Day 38., Proportion of participants with no [CCI], Proportion of participants with evidence of recurrent or persistent SARS-CoV-2 infection, [CCI], Proportion of participants with COVID-19-related ED visits with administration of supplemental oxygen, COVID-19 antiviral, or IV treatment (eg, hydration, antibiotics, or corticosteroids), COVID-19-related hospitalization, or all-cause mortality through Day 38., Change from baseline in SARS-CoV-2 RNA level in NP or nasal swabs over time., Proportion of participants with SARS-CoV-2 NP or nasal RNA< LLOQ at each time point through Day 38., Proportion of participants with viral rebound in SARS-CoV-2 RNA level in NP or nasal swabs through Day 38 visit (in both virologic responders and regardless of virologic response)., Time to sustained NP or nasal swab SARS-CoV-2 RNA< LLOQ through Day 38., Incidence of treatment-emergent adverse events (TEAEs)., Incidence of serious adverse events (SAEs) and adverse events (AEs) leading to discontinuations.

Source: https://euclinicaltrials.eu/ctis-public/view/2024-517671-21-00